EU clinical trial 2022-503058-37-00: An International, Phase 3, Randomized, Multicenter, Open-label Study of Ripretinib vs Sunitinib in Patients with Advanced Gastrointestinal Stromal Tumor (GIST) with KIT Exon 11 and Co-occurring KIT Exons 17 and/or 18 Mutations Who Were Previously Treated with Imatinib (INSIGHT)
Protocol code: DCC-2618-03-003
Sponsor: Deciphera Pharmaceuticals Inc. (Pharmaceutical company). Phase: Therapeutic confirmatory (Phase III). Countries: Norway (ongoing, recruitment ended), France (ongoing, recruitment ended), Germany (ongoing, recruitment ended), Netherlands (ongoing, recruitment ended), Spain (ongoing, recruitment ended), Poland (ended), Hungary (ended), Italy (ongoing, recruitment ended).
Therapeutic area(s): Diseases [C] - Neoplasms [C04]
Gender: Female, Male. Age: 18-64 years, 65+ years. Enrolment: 30.
Start date (EU): 2023-11-10. Decision date: 2023-08-21. Results received: No. Last updated: 2026-07-27.
Decision dates by country: HU: 2023-08-28, PL: 2023-08-28, IT: 2023-08-25, ES: 2023-08-23, NL: 2023-08-21, DE: 2023-08-22, NO: 2024-08-08, FR: 2023-08-21

Condition(s): Advanced Gastrointestinal Stromal Tumor
Product: QINLOCK 50 mg tablets, Sunitinib AqVida 12,5 mg Hartkapseln

Primary endpoint: PFS based on IRR per mRECIST, which is defined as the time from randomization until documented progressive disease (PD) based on IRR per mRECIST or death due to any cause, whichever occurs first.
Endpoint(s): To compare ORR by IRR of ripretinib vs sunitinib using mRECIST, To compare OS of ripretinib vs sunitinib, Summary measures from the EORTC-QLQ-C30, NCI-PRO-CTCAE items (questions number 15 “constipation”, 16 “diarrhea”, 30 “hand-foot syndrome”, and 53a and b “fatigue”), and the EQ-5D-5L, Time-to-progression based on IRR per mRECIST, which is defined as the time from randomization until documented progressive disease based on IRR per mRECIST, Disease control rate at 6, 12, 18, and 24 weeks based on IRR per mRECIST, which is defined as the proportion of participants who achieve complete response (CR), partial response (PR), or stable disease (SD) at the specified time point based on IRR per mRECIST, Progression-free survival based on the Investigator per mRECIST, which is defined as the time from randomization until documented PD based on Investigator’s assessment per mRECIST or death due to any cause, whichever occurs first, Duration of response for participants who achieve confirmed CR or PR, defined as the time interval from the time that the measurement criteria are first met for confirmed CR or confirmed PR (whichever is first recorded) until the first date the PD is objectively documented or death, whichever occurs first, Time-to-response is defined as the time from date of randomization until the first assessment of confirmed CR or PR per mRECIST, PFS2, which is defined as the time from randomization until PD on next-line treatment as determined by the Investigator, or death due to any cause, whichever occurs first − Second PFS, which is defined as the date of the first dose of next-line treatment until PD based on Investigator assessment or death due to any cause, whichever occurs first

Source: https://euclinicaltrials.eu/ctis-public/view/2022-503058-37-00